EU clinical trial 2023-507177-17-00: A Study of LY3200882 in Participants With Solid Tumors.
Protocol code: I8X-MC-JECA
Sponsor: Eli Lilly & Co. (Pharmaceutical company). Phase: Human Pharmacology (Phase I)- First administration to humans. Countries: Spain (ongoing, recruitment ended).
Therapeutic area(s): Diseases [C] - Neoplasms [C04]
Gender: Female, Male. Age: 18-64 years, 65+ years. Enrolment: 1.
Status: Ongoing, recruitment ended. Start date (EU): 2016-11-21. Decision date: 2024-02-27. Results received: No. Last updated: 2024-11-15.
Decision dates by country: ES: 2024-04-12

Condition(s): Metastatic cancer, Solid Tumor

Source: https://euclinicaltrials.eu/ctis-public/view/2023-507177-17-00